EU clinical trial 2023-509680-25-00: A New Intervention for Implementation of Pharmacogenetics in Psychiatry
Protocol code: NL79649.068.21
Sponsor: Parnassia Groep B.V. (Hospital/Clinic/Other health care facility). Phase: Therapeutic use (Phase IV). Countries: Germany (ongoing, recruiting), Spain (ongoing, recruiting), Netherlands (ongoing, recruiting).
Therapeutic area(s): Psychiatry and Psychology [F] - Mental Disorders [F03]
Gender: Female, Male. Age: 18-64 years. Enrolment: 1470.
Status: Ongoing, recruiting. Start date (EU): 2025-06-03. Decision date: 2024-11-08. Results received: No. Last updated: 2026-03-31.
Decision dates by country: ES: 2024-11-08, DE: 2024-11-12, NL: 2026-03-31

Condition(s): Mood disorder (major depressive disorder and bipolar disorder (currently depressive episode)) Anxiety disorder (panic disorder, social phobia, specific phobia, agoraphobia, generalised anxiety disorder) Psychotic disorder (schizophrenia and schizoaffective disorder)
Product: ESCITALOPRAM, RISPERIDONE, ARIPIPRAZOLE, SERTRALINE

Primary endpoint: Patient recovery at 24 weeks, as assessed using the patient recovery assessment scale (RAS, RAS-DS))
Endpoint(s): Well-being and quality of life (EuroQol 5 Dimensions-5 levels questionnaire; EQ-5D-5L). Psychosocial functioning (Functioning Assessment Short Test (FAST)). Clinical symptomatology (SIGH-D; for patients with mood disorders), (SIGH-A; anxiety disorders), and the PANSS (for psychotic patients). Side effects (Frequency, Intensity and Burden of side effects ratings (FIBSER) and the Udvalg for Kliniske Undersogelse – Side Effects Rating Scale (UKU-SERS)). Obtained over a 24-week period

Source: https://euclinicaltrials.eu/ctis-public/view/2023-509680-25-00